EU clinical trial 2025-521962-83-00: AdaptNK –Cell Therapy for High-risk Myeloid Disease
Sponsor: Karolinska Institutet (Educational Institution). Phase: Phase I and Phase II (Integrated)- Other. Countries: Sweden (authorised, recruitment pending).
Therapeutic area(s): Diseases [C] - Neoplasms [C04]; Diseases [C] - Hemic and Lymphatic Diseases [C15]
Gender: Female, Male. Age: 18-64 years, 65+ years. Enrolment: 26.
Status: Authorised, recruitment pending. Decision date: 2026-01-19. Results received: No. Last updated: 2026-01-19.

Condition(s): Relapsed and/or refractory AML or MDS

Source: https://euclinicaltrials.eu/ctis-public/view/2025-521962-83-00